EU clinical trial 2024-515156-21-00: C5041012 (APD334-303) - An Open-Label Extension Study of Etrasimod in Subjects with Moderately to Severely Active Ulcerative Colitis
Protocol code: C5041012(APD334-303)
Sponsor: Arena Pharmaceuticals Inc. (Pharmaceutical company). Phase: Therapeutic confirmatory (Phase III). Countries: Poland (ongoing, recruitment ended), Portugal (ongoing, recruitment ended), Hungary (ongoing, recruitment ended), Czechia (ongoing, recruitment ended), Romania (ongoing, recruitment ended), Slovakia (ongoing, recruitment ended), Spain (ended), France (ongoing, recruitment ended), Belgium (ongoing, recruitment ended), Estonia (ongoing, recruitment ended), Italy (ongoing, recruitment ended), Germany (ongoing, recruitment ended), Bulgaria (ongoing, recruitment ended), Lithuania (ongoing, recruitment ended).
Therapeutic area(s): Diseases [C] - Digestive System Diseases [C06]
Gender: Female, Male. Age: 0-17 years, 18-64 years, 65+ years. Enrolment: 298.
Start date (EU): 2020-01-09. Decision date: 2024-09-24. Results received: No. Last updated: 2026-07-13.
Decision dates by country: BE: 2024-09-26, EE: 2024-09-27, FR: 2024-09-25, DE: 2024-10-08, LT: 2024-11-20, ES: 2024-09-24, IT: 2024-11-04, HU: 2024-09-24, SK: 2024-09-24, PL: 2024-09-25, BG: 2024-10-04, CZ: 2024-09-25, RO: 2024-09-30, PT: 2024-09-27

Condition(s): Ulcerative Colitis
Product: Etrasimod Arginine Blue

Primary endpoint: Incidence of treatment-emergent adverse events (TEAEs) and serious adverse events (SAEs), Incidence and severity of laboratory abnormalities, and change from treatment baseline in laboratory values (hematology, serum chemistry, coagulation, and urinalysis), Incidence of vital sign abnormalities and changes from treatment baseline
Endpoint(s): The proportion of subjects achieving clinical remission at Weeks 52 and 104, The proportion of subjects achieving clinical remission at Weeks 52 and 104, among subjects achieving clinical remission at study entry, The proportion of subjects achieving clinical response at Weeks 52 and 104, Change from baseline in the Total Mayo Score (TMS) at Weeks 52 and 104, Change from baseline in Partial Mayo Score (PMS) at each of the following weeks: Weeks 52, 104, 156, 208, and 260, The proportion of subjects achieving endoscopic improvement at Weeks 52 and 104

Source: https://euclinicaltrials.eu/ctis-public/view/2024-515156-21-00